EU clinical trial 2023-509914-12-00: A Phase I, Randomized, Partial Double-blind, Single dose, 3-Way Cross-over Study to Assess the Lung Exposure Bioequivalence of Budesonide, Glycopyrronium, and Formoterol for BGF MDI HFO Compared with BGF MDI HFA Using an AeroChamber Plus Flow-Vu Spacer and to Compare the Lung Exposure of BGF MDI HFO with a Spacer to BGF MDI HFO without a Spacer
Protocol code: D5985C00009
Sponsor: AstraZeneca AB (Pharmaceutical company). Phase: Human Pharmacology (Phase I)- Bioequivalence Study. Countries: Germany (ended).
Therapeutic area(s): Not possible to specify
Gender: Female, Male. Age: 18-64 years. Enrolment: 132.
Status: Ended. Start date (EU): 2024-04-29. End date (EU): 2024-08-02. Decision date: 2024-04-22. Results received: No. Last updated: 2024-07-23.

Condition(s): Not applicable, healthy volunteers

Source: https://euclinicaltrials.eu/ctis-public/view/2023-509914-12-00